EU clinical trial 2022-500299-71-00: BELASBRIDGE : Belatacept as a replacement for CNIs 3 to 12 months post-transplantation in patients with early graft dysfunction
Protocol code: RC21_0587
Sponsor: Centre Hospitalier Universitaire De Nantes (Hospital/Clinic/Other health care facility). Phase: Therapeutic exploratory (Phase II). Countries: France (ongoing, recruitment ended).
Therapeutic area(s): Diseases [C] - Pathological Conditions, Signs and Symptoms [C23]
Gender: Female, Male. Age: 18-64 years, 65+ years. Enrolment: 28.
Status: Ongoing, recruitment ended. Start date (EU): 2024-05-03. Decision date: 2022-05-19. Results received: No. Last updated: 2026-04-22.

Condition(s): Kidney transplant
Product: NULOJIX 250 mg powder for concentrate for solution for infusion

Primary endpoint: The feasibility of reintroduction of CNIs will be defined by preserved renal function and good tolerance at 6months post reintroduction (15months follow-up) in patients who have been switched back to CNI at M9.Renal function will be defined as preserved if creatinine clearance (according to CKD-EPI) does not decrease by more than 25% after discontinuation of belatacept.Good tolerance of the reinstatement of CNIs will be defined by absence of complications leading to discontinuation of treatment.
Endpoint(s): Longitudinal monitoring of renal function (M0, M3, M6, M9), collection of rejection events., Collection of infectious episodes and neoplasia., Number of care resources consumed in relation to treatments (drugs, hospitalisation, transport, consultations, biological procedures, medical procedures, possible home help) and associated costs over 15 months of follow-up, and collection of cost data from the literature for comparison., Measurement of quality of life scores (generic EQ-5D scale) every 3 months for 15 months and collection of quality of life data from the literature for comparison., Differential analysis (before and after belatacept discontinuation) of cell populations by standardised flow cytometry combined with unbiased analysis., Differential analysis (before and after belatacept discontinuation) of the anti-CMV cellular immune response.

Source: https://euclinicaltrials.eu/ctis-public/view/2022-500299-71-00